EU clinical trial 2023-505431-12-00: M1774 (oral ATR inhibitor) in Combination with PLX038 (Topo1 inhibitor) with dose expansion cohorts in patients with advanced solid tumors
Protocol code: IC 2022-10
Sponsor: Institut Curie (Hospital/Clinic/Other health care facility). Phase: Human Pharmacology (Phase I)- First administration to humans. Countries: France (ended).
Therapeutic area(s): Diseases [C] - Neoplasms [C04]
Gender: Female, Male. Age: 18-64 years, 65+ years. Enrolment: 92.
Status: Ended. Start date (EU): 2025-01-20. End date (EU): 2025-11-24. Decision date: 2024-03-11. Results received: No. Last updated: 2025-12-17.

Condition(s): Patients with pretreated, metastatic or locally advanced cancer for the dose escalation part and dose expansion cohorts in patients with advanced triple-negative breast cancers and advanced cancers with ATM mutation.

Source: https://euclinicaltrials.eu/ctis-public/view/2023-505431-12-00